EU clinical trial 2024-519234-23-00: Imaging neural correlates of antidepressant action of ketamine stereoisomers using pharmacological PET/MR imaging and metabolite analysis.
Protocol code: RS-Ket_PETMR
Sponsor: Medical University Of Vienna (Educational Institution). Phase: Human Pharmacology (Phase I)- Other. Countries: Austria (ongoing, recruiting).
Therapeutic area(s): Not possible to specify; Psychiatry and Psychology [F] - Mental Disorders [F03]
Gender: Female, Male. Age: 18-64 years. Enrolment: 75.
Status: Ongoing, recruiting. Start date (EU): 2020-01-17. Decision date: 2025-01-30. Results received: No. Last updated: 2025-01-30.

Condition(s): Healthy volunteers - no medical condition
Product: Ketamin-hameln 50 mg/ml Injektionslösung, Saline Solution Basi 9 mg/ml solution for infusion, Ketanest® S 25 mg/ml - Ampullen

Primary endpoint: regional cerebral metabolic rate of glucose (rCMRGlu), cerebral blood flow (CBF), functional connectivity (FC), Volumen (GMV), mean diffusivity (MD), fractional anisotropy (FA)
Endpoint(s): Psychopathological effects of administration of the study medication

Source: https://euclinicaltrials.eu/ctis-public/view/2024-519234-23-00